EU clinical trial 2023-504630-22-00: Clinical Study of Antibody-Drug Conjugate MYTX-011 in Subjects With Non-Small Cell Lung Cancer
Protocol code: MYTX-011-01
Sponsor: Mythic Therapeutics Inc. (Pharmaceutical company). Phase: Phase I and Phase II (Integrated)- First administration to humans. Countries: France (ended), Spain (ended).
Therapeutic area(s): Diseases [C] - Neoplasms [C04]
Gender: Female, Male. Age: 18-64 years, 65+ years. Enrolment: 60.
Status: Ended. Start date (EU): 2024-04-19. End date (EU): 2025-11-01. Decision date: 2024-02-21. Results received: No. Last updated: 2025-05-16.
Decision dates by country: FR: 2024-02-21, ES: 2024-02-26

Condition(s): Non-Small Cell Lung Cancer

Source: https://euclinicaltrials.eu/ctis-public/view/2023-504630-22-00